EU clinical trial 2024-515582-33-00: A Phase 1 Open-label, Multicenter, Dose Escalation Study of the Safety, Tolerability, and Pharmacokinetics of HPN217 in Patients with Relapsed/Refractory Multiple Myeloma
Protocol code: MK-4002-001
Sponsor: Harpoon Therapeutics Inc. (Pharmaceutical company). Phase: Human Pharmacology (Phase I)- First administration to humans. Countries: Spain (ended), France (ended).
Therapeutic area(s): Diseases [C] - Neoplasms [C04]
Gender: Female, Male. Age: 18-64 years, 65+ years. Enrolment: 10.
Status: Ended. Start date (EU): 2020-10-26. End date (EU): 2026-04-08. Decision date: 2024-09-11. Results received: No. Last updated: 2026-04-24.
Decision dates by country: FR: 2024-09-30, ES: 2024-09-11

Condition(s): Relapsed/Refractory Multiple Myeloma (RRMM), Recurrent Multiple Myeloma that does not respond to treatment

Source: https://euclinicaltrials.eu/ctis-public/view/2024-515582-33-00